EU clinical trial 2023-504974-40-00: SERENA-2: A Randomised, Open-Label, Parallel-Group, Multicentre Phase 2 Study Comparing the Efficacy and Safety of Oral AZD9833 versus Fulvestrant in Women with Advanced ER-Positive HER2-Negative Breast Cancer
Protocol code: D8530C00002
Sponsor: AstraZeneca AB (Pharmaceutical company). Phase: Therapeutic exploratory (Phase II). Countries: Belgium (ended), Hungary (ended), France (ended), Italy (ended), Portugal (ended), Spain (ended), Poland (ongoing, recruitment ended).
Therapeutic area(s): Diseases [C] - Neoplasms [C04]
Gender: Female. Age: 18-64 years, 65+ years. Enrolment: 30.
Start date (EU): 2020-04-24. Decision date: 2024-09-09. Results received: No. Last updated: 2026-03-23.
Decision dates by country: BE: 2024-09-09, FR: 2024-09-13, HU: 2024-09-10, PT: 2024-09-12, ES: 2024-09-11, PL: 2024-10-05, IT: 2024-09-17

Condition(s): Estrogen Receptor Positive HER2 Negative Advanced Breast Cancer
Product: FULVESTRANT, camizestrant, camizestrant

Primary endpoint: Progression-free survival
Endpoint(s): Objective response rate, Duration of response, Percentage change in tumour size in tumour size at 16 weeks, Overall survival, Clinical benefit rate at 24 weeks, Plasma concentrations of AZD9833 and, if appropriate, metabolite(s), Percent change from baseline in ER and progesterone receptor (PgR) expression assessed by the manual H-score method, Percent change from baseline in Ki67 labelling index., Changes from baseline in total/subscale scores of the HrQoL questionnaires.

Source: https://euclinicaltrials.eu/ctis-public/view/2023-504974-40-00